EU clinical trial 2025-522257-19-00: Ublituximab in Pediatric Participants with Relapsing forms of Multiple Sclerosis (RMS)
Protocol code: TG1101-RMS-PED304
Sponsor: Tg Therapeutics Inc. (Pharmaceutical company). Phase: Phase II and Phase III (Integrated). Countries: Poland (ongoing, recruiting), Slovakia (authorised, recruitment pending).
Therapeutic area(s): Diseases [C] - Nervous System Diseases [C10]
Gender: Female, Male. Age: 0-17 years. Enrolment: 48.
Start date (EU): 2026-05-12. Decision date: 2025-12-22. Results received: No. Last updated: 2026-08-03.
Decision dates by country: PL: 2025-12-22, SK: 2026-03-30

Condition(s): Relapsing Multiple Sclerosis
Product: ublituximab, FINGOLIMOD, Ublituximab Placebo, Fingolimod placebo

Primary endpoint: (Part C) Safety a. Incidence and severity of AEs, with severity determined according to NCI CTCAE v5.0 b. Suicidal Ideation Columbia-Suicide Severity Rating Scale (C-SSRS), (Part A) Percentage of patients with CD19+ B cell at a defined level
Endpoint(s): Part A: Safety a. Incidence and severity of AEs, with severity determined according to NCI CTCAE v5.0 b. Suicidal ideation Columbia-Suicide Severity Rating Scale (C-SSRS), Part A: Pharmacology a. Serum concentrations of ublituximab b. Percentage of participants with anti-drug antibodies (ADAs) to ublituximab, Part B: Safety a. Incidence and severity of AEs, with severity determined according to NCI CTCAE v5.0 b. Suicidal ideation Columbia-Suicide Severity Rating Scale (C-SSRS), Part B: Pharmacology a. Calculated PK parameters of ublituximab b. CD19+ B cell counts c. Percentage of participants with Treatment Emergent Anti-Drug Antibody(TE-ADAs) to ublituximab

Source: https://euclinicaltrials.eu/ctis-public/view/2025-522257-19-00